EU clinical trial 2023-506084-34-00: A Study to Evaluate the Efficacy and Safety of Once-weekly Insulin Icodec when Switching from Daily Basal Insulins Compared to Once-daily Insulin Glargine U100 in Adults with Type 2 Diabetes
Protocol code: NN1436-7724
Sponsor: Novo Nordisk A/S (Pharmaceutical company). Phase: Therapeutic confirmatory (Phase III). Countries: Poland (ended), Spain (ended), Bulgaria (ended), Germany (ended).
Therapeutic area(s): Diseases [C] - Nutritional and Metabolic Diseases [C18]
Gender: Female, Male. Age: 18-64 years, 65+ years. Enrolment: 145.
Status: Ended. Start date (EU): 2024-04-12. End date (EU): 2025-06-13. End date: 2025-06-14. Decision date: 2024-03-26. Results received: Yes. Last updated: 2026-02-03.
Decision dates by country: PL: 2024-04-02, DE: 2024-03-27, ES: 2024-03-26, BG: 2024-03-29

Condition(s): Type 2 Diabetes
Product: Lantus SoloStar 100 units/ml solution for injection in a pre-filled pen, insulin icodec 700 U/mL PDS290

Primary endpoint: Change in HbA1c from baseline week 0 (V6) to week 26 (V32)
Endpoint(s): Change in time in range 3.9–10.0 mmol/L (70–180 mg/dL), Change in DTSQs (Diabetes Treatment Satisfaction Questionnaire status version) total treatment satisfaction, Number of severe hypoglycaemic episodes (level 3) (safety), Number of clinically significant hypoglycaemic episodes (level 2) (<3.0 mmol/L (54 mg/dL), confirmed by BG meter) (safety), Number of clinically significant hypoglycaemic episodes (level 2) (<3.0 mmol/L (54 mg/dL), confirmed by BG meter) or severe hypoglycaemic episodes (level 3), Time spent < 3.0 mmol/L (54 mg/dL), Change in time spent > 10.0 mmol/L (180 mg/dL), Mean weekly insulin dose, Change in body weight

Source: https://euclinicaltrials.eu/ctis-public/view/2023-506084-34-00